EU clinical trial 2024-518402-40-00: Time restricted Eating And Metformin (TEAM) in invasive breast cancer (IBC) or ductal carcinoma in situ (DCIS). A randomized, phase IIb, window of opportunity presurgical trial.
Sponsor: Ente Ospedaliero Ospedali Galliera Di Genova (Hospital/Clinic/Other health care facility). Phase: Therapeutic exploratory (Phase II). Countries: Italy (authorised, recruitment pending).
Therapeutic area(s): Diseases [C] - Neoplasms [C04]
Gender: Female. Age: 18-64 years, 65+ years. Enrolment: 90.
Status: Authorised, recruitment pending. Decision date: 2024-11-25. Results received: No. Last updated: 2025-03-26.

Condition(s): Luminal (ER+ve and/or PgR+ve >=1%) invasive breast cancer or ductal carcinoma in situ
Product: GLUCOPHAGE UNIDIE 750 mg compresse a rilascio prolungato

Primary endpoint: Frequency of occurrence of dose limiting toxicity in the first 14 patients in the experimental arm (interim endpoint); change in pre-post treatment immunohistochemical Ki67 LI in IBC or DCIS (in the absence of IBC) (primary) and difference in post-treatment adjacent DCIS (in the presence of IBC), if present, or IEN (defined as ADH/ALH/LCIS) Ki67 (co-primary) between arms.

Source: https://euclinicaltrials.eu/ctis-public/view/2024-518402-40-00